EU clinical trial 2024-514395-40-00: Phase II, randomized, open-label, international, multicenter study to compare efficacy of standard chemotherapy vs. letrozole plus abemaciclib as neoadjuvant therapy in HR-positive/HER2-negative high/intermediate risk breast cancer patients “CARABELA Study”
Protocol code: GEICAM/2019-01
Sponsor: Fundacion Grupo Espanol De Investigacion En Cancer De Mama (Patient organisation/association). Phase: Therapeutic exploratory (Phase II). Countries: Spain (ongoing, recruitment ended).
Therapeutic area(s): Diseases [C] - Neoplasms [C04]
Gender: Female. Age: 18-64 years, 65+ years. Enrolment: 200.
Status: Ongoing, recruitment ended. Start date (EU): 2020-08-25. Decision date: 2024-10-10. Results received: No. Last updated: 2025-07-25.

Condition(s): High/intermediate risk hormone receptor (HR) positive/human epidermal growth factor receptor 2 (HER2) negative breast cancer patients with indication of neoadjuvant therapy.
Product: Verzenios 50 mg film-coated tablets

Primary endpoint: Evaluation of the number of patients with a Residual Cancer Burden (RCB) 0-I index as a measure of efficacy. RCB is a continuous variable derived from the primary tumor dimensions, cellularity of the tumor bed, and axillary nodal burden. It is estimated from routine pathological sections of the primary breast tumor site and the regional lymph nodes after the completion of neoadjuvant therapy.
Endpoint(s): Percentage of decrease in the geometric mean of Ki67 index value after 2 weeks of treatment in both treatments arms. Number of patients with cell cycle arrest (Ki67 < 2.7%) after 2 weeks of treatment in both treatment arms., RCB is classified in four classes based on the residual disease (RD): o RCB-0 defined as pathological complete response. o RCB-I defined as minimal RD. o RCB-II defined as moderate RD. o RCB-III defined as extensive RD., Variation of RCB value based on the RD between both treatment arms., PEPI (Preoperative Endocrine Prognostic Index)(24) requires pathological stage (tumor size and nodal status), level of Ki67 protein and Allred ER score measured on the surgical specimen. PEPI score 0 includes pT1 or pT2, pN0, Ki67 ≤ 2.7%, Allred score > 2., Clinical Response Rate (CRR) is defined as the proportion of subjects with complete or partial radiographic response. Complete response (CR) and partial response (PR) definitions are assessed by MRI at baseline and prior to breast surgery, with or without regional lymph nodes surgery, and categorized according to percent reduction in tumor size., Rate of breast conserving surgery (BCS): defined as the proportion of patients who achieved BCS between both treatment arms., Invasive event free survival (iEFS): defined as time from randomization to progressive disease or invasive disease recurrence or death from any cause. Invasive disease recurrence is defined as: o Ipsilateral invasive breast tumor recurrence (including second primary invasive breast cancer) o Ipsilateral regional invasive breast cancer recurrence. o Distant recurrence o Contralateral invasive breast cancer o Second primary invasive cancer of non-breast origin., Safety will be assessed by standard clinical and laboratory tests (hematology, serum chemistry). AEs grade will be defined by the NCI-CTCAE version 5.0. AEs terms will be coded according to MedDRA dictionary., Gene expression data provided by a multigene expression panel in sequential tumor biopsies.

Source: https://euclinicaltrials.eu/ctis-public/view/2024-514395-40-00